EU clinical trial 2024-513835-25-00: A Phase 3, Double-Blind, Randomized, Placebo-Controlled, Parallel Group, Multicenter Study to Evaluate the Efficacy, Safety, Tolerability, and Pharmacokinetics of Masupirdine (SUVN-502) for the Treatment of Agitation in Participants with Dementia of the Alzheimer's Type
Protocol code: CTP3S1502HT6
Sponsor: Suven Life Sciences Limited (Pharmaceutical company). Phase: Therapeutic confirmatory (Phase III). Countries: Poland (ongoing, recruitment ended), Croatia (ongoing, recruitment ended).
Therapeutic area(s): Diseases [C] - Nervous System Diseases [C10]
Gender: Female, Male. Age: 18-64 years, 65+ years. Enrolment: 157.
Status: Ongoing, recruitment ended. Start date (EU): 2022-10-27. Decision date: 2024-06-24. Results received: No. Last updated: 2026-07-16.
Decision dates by country: PL: 2024-06-24, HR: 2024-06-25

Condition(s): Agitation with Dementia of the Alzheimer's Type
Product: Masupirdine, Masupirdine, PL1

Primary endpoint: Change in CMAI items score aligning to the IPA agitation criteria domains from baseline to Week 12
Endpoint(s): Improvement in mADCS-CGI-C at Week 12, Change in CGI-S score as related to agitation from baseline to Week 12, Change in CaGI-S score as related to agitation from baseline to Week 12, Improvement in CaGI-C at Week 12, Change in behavioral and psychological symptoms as measured by NPI-12 from baseline to Week 12, Change in memory and cognitive behaviors as studied using MMSE total score from baseline to Week 12, Change in CMAI items score aligning to the IPA agitation criteria domains from baseline to Weeks 2, 4, and 8, Change in C-SDD from baseline to Week 12

Source: https://euclinicaltrials.eu/ctis-public/view/2024-513835-25-00